EU clinical trial 2023-503572-24-00: A Phase III, Multicentre, Randomized, Double-blind, Chronic-dosing, Parallel-group, Placebo-controlled Study to Evaluate the Efficacy and Safety of Two Dose Regimens of Tozorakimab in Participants with Symptomatic Chronic Obstructive Pulmonary Disease (COPD) with a History of COPD Exacerbations (TITANIA)
Protocol code: D9180C00004
Sponsor: AstraZeneca AB (Pharmaceutical company). Phase: Therapeutic confirmatory (Phase III). Countries: Poland (ended), Germany (ended), Italy (ended), France (ended), Romania (ended), Greece (ended).
Therapeutic area(s): Diseases [C] - Respiratory Tract Diseases [C08]
Gender: Female, Male. Age: 18-64 years, 65+ years. Enrolment: 350.
Status: Ended. Start date (EU): 2022-03-02. End date (EU): 2026-02-12. End date: 2026-03-22. Decision date: 2024-04-03. Results received: No. Last updated: 2026-01-30.
Decision dates by country: DE: 2024-04-03, PL: 2024-04-09, GR: 2024-06-17, IT: 2024-04-26, RO: 2024-04-08, FR: 2024-05-03

Condition(s): Chronic Obstructive Pulmonary Disease (COPD)
Product: SALBUTAMOL, Tozorakimab, Tozorakimab-placebo

Primary endpoint: 1. Annualized rate of moderate to severe COPD exacerbations in participants who are former smokers.

Source: https://euclinicaltrials.eu/ctis-public/view/2023-503572-24-00